EU clinical trial 2024-513958-29-00: Semaglutide for people with obesity and resistant hypertension (SUPPORT): a pilot, randomized, parallel-group, integrated, multicentre clinical trial.
Protocol code: TRI CRF 23-05
Sponsor: Trinity College Dublin (Educational Institution). Phase: Therapeutic confirmatory (Phase III). Countries: Ireland (ongoing, recruitment ended).
Therapeutic area(s): Diseases [C] - Cardiovascular Diseases [C14]
Gender: Female, Male. Age: 18-64 years, 65+ years. Enrolment: 50.
Status: Ongoing, recruitment ended. Start date (EU): 2025-04-24. Decision date: 2025-01-31. Results received: No. Last updated: 2026-07-21.

Condition(s): Cardiovascular disorders: Hypertension and Obesity
Product: Ozempic 0.25 mg solution for injection in pre-filled pen, Wegovy 1 mg FlexTouch solution for injection in pre-filled pen, Wegovy 1.7 mg FlexTouch solution for injection in pre-filled pen, Wegovy 2.4 mg FlexTouch solution for injection in pre-filled pen, Wegovy 0.5 mg FlexTouch solution for injection in pre-filled pen, Ozempic 0.5 mg solution for injection in pre-filled pen, Wegovy 0.25 mg FlexTouch solution for injection in pre-filled pen, The Placebo for use in this trial refers to an injection with an empty medical syringe with a needle attached. To ensure sterility and safety, a new sterile needle will be used for each administration. An accompanying training pen will be held by the research nurse during administration, and this will be ‘clicked’ to replicate the sound of a pre-filled pen administration. The medical syringe used in this trial is a BD Luer-Lok™ Syringe and the needles ® attached to it are CE-Marked. The accompanying training pen is a commercial authorized CE-Marked pen., Ozempic 1 mg solution for injection in pre-filled pen, Ozempic 0.5 mg solution for injection in pre-filled pen, Ozempic 0.5 mg solution for injection in pre-filled pen, Ozempic 0.5 mg solution for injection in pre-filled pen, Ozempic 0.5 mg solution for injection in pre-filled pen, Ozempic 0.5 mg solution for injection in pre-filled pen, Ozempic 0.5 mg solution for injection in pre-filled pen

Primary endpoint: Blood pressure measurement: Variability in mean difference in systolic BP (SBP) after 36 weeks. Correlation between home, ambulatory and clinic SBP., Trial conduct: Recruitment feasibility and reliability - numbers of participants screened, consented, randomized and with final results. Site feasibility - number of sites recruited and site performance (numbers of participants recruited)., Intervention acceptability: Tolerability of the intervention measured by treatment related participant discontinuation. Participant drop-out, Safety: Proportion, incidence and severity of serious adverse events in those who have taken at least one dose of the intervention., Safety: Routine follow-up records the incidence of drug related adverse events of interest and those related to blood pressure lowering if they require medical assessment or hospital admission: Severe gastrointestinal symptoms (preventing everyday activities) • Acute pancreatitis (Atlanta classification).[Banks,2013] • Hypotensive episodes requiring medical review e.g. syncope, falls due to orthostatic symptoms • Acute kidney injury (KDIGO definition)
Endpoint(s): Clinical: For all randomized patients administered semaglutide compared with placebo, both in addition to healthy lifestyle advice, from baseline to 36 weeks: • Mean difference in home systolic BP • Change in anti-hypertensive medications, • Mean difference in home diastolic BP, • Mean difference in body weight, • Mean difference in ambulatory* and clinic systolic and diastolic BP, • Mean difference in glycated haemoglobin (HbA1c), Patient reported: Comparing the trial arm treated with semaglutide with placebo, both in addition to a healthy lifestyle intervention, from baseline to week 36 for: • Change in health-related quality-of-life using the EQ-5D-3L, • Change in health beliefs using the Beliefs about Medicines questionnaire, • Change in medication adherence using the Hill-Bone questionnaire, • Change in health lifestyle behaviours using the Best Health Program questionnaire., Exploratory: Composite BP change (mean difference in SBP and mean difference in expected mean difference in BP as a result of alterations to anti-hypertensive medications using a treatment intensity score). Novel measures of BP control including SBP Load and Time in Target Range.

Source: https://euclinicaltrials.eu/ctis-public/view/2024-513958-29-00